EU clinical trial 2025-523476-23-00: Tick-Borne Encephalitis (TBE) Remdesivir Efficacy Assessment Trial (TREAT) – A phase 2 proof-of-concept, national, multicenter, randomized, double-blind, placebo-controlled clinical study designed to evaluate the efficacy of remdesivir in adult patients hospitalized for TBE
Protocol code: TREAT
Sponsor: Region Stockholm – SLSO (Hospital/Clinic/Other health care facility). Phase: Therapeutic exploratory (Phase II). Countries: Sweden (authorised, recruitment pending).
Therapeutic area(s): Diseases [C] - Virus Diseases [C02]
Gender: Female, Male. Age: 18-64 years, 65+ years. Enrolment: 126.
Status: Authorised, recruitment pending. Decision date: 2026-02-12. Results received: No. Last updated: 2026-02-12.

Condition(s): Tick-Borne Encephalitis (TBE)
Product: REMDESIVIR, ELECTROLYTES

Primary endpoint: S-NfL level at Week 4 after initiation of treatment, analyzed comparatively between the remdesivir and placebo arms.
Endpoint(s): Comprehensive cognitive testing targeting memory and learning, working memory, processing speed, attention and executive functions, operationalized as a composite cognitive score and also analyzed as individual test scores. Measured at week 12, 26 and 52, after treatment start, using a CE-marked digital neurocognitive test battery, analyzed comparatively between treatment arms. Cognitive screening (MoCA) performed in early phase (week 4)., Fatigue Severity Scale measured at week 4, 12, 26 and 52, after treatment start, analyzed comparatively between treatment arms., Visual Analogue Scale (VAS) scores at Day 1, 5 and, if longer duration of treatment, also on the last day of treatment. Analyzed comparatively between treatment arms., Detailed methods to record AEs and SAEs are described in section 9.3. The definition of SAEs is included in this study protocol in section 9.1., • Number of hospital-free days alive during study participation. • Mortality at End of Trial • Days on advanced respiratory support from Start to End of Trial • Neurological status (46) at Week 12 compared to at start of treatment. • Patient questionnaire (SF-36) assessing self-reported health-related quality of life, at week 4, 12, 26 and 52. Analyzed comparatively between treatment arms., Time from hospitalization to start of treatment in relation to NfL/GFAP and/or the composite cognitive score at Week 4 in the remdesivir arm., Number of days of remdesivir treatment (5, 6, 7, 8, 9 or 10 days) in relation to NfL/GFAP and/or the composite cognitive score at Week 4 in the remdesivir arm., Time from anamnestic fever onset to treatment initiation in relation to NfL/GFAP and/or the composite cognitive score at Week 4, analyzed comparatively between treatment arms., Number and timing of previous TBE-, Yellow Fever -or Japanese Encephalitis vaccinations in relation to NfL/GFAP and/or the composite cognitive score at Week 4, analyzed comparatively between treatment arms., Sex, anamnestic height and weight (BMI), comorbidities, age in relation to NfL/GFAP the composite cognitive score at Week 4, analyzed comparatively between treatment arms., Concomitant medication use in relation to NfL/GFAP and/or the composite cognitive score at Week 4, analyzed comparatively between treatment arms., Tick-borne co-infections confirmed by blood analysis in relation to NfL/GFAP and/or the composite cognitive score at Week 4, analyzed comparatively between treatment arms., S-NfL levels at time points other than Week 4 (i.e., Day 1, Day 5, Week 4, Week 12, and Week 52), analyzed comparatively between treatment arms., CSF neurofilament concentrations before and after treatment initiation (i.e., Day 1, Day 5, Week 4 and Week 12), analyzed comparatively between treatment arms., GFAP levels in blood and/or CSF before and after treatment initiation (i.e., Day 1, Day 5, Week 4, Week 12, and Week 52), analyzed comparatively between treatment arms., Concentrations of remdesivir and GS-441524 in CSF, blood, and/or urine on Day 5 in relation to NfL/GFAP and/or the composite cognitive score at Week 4 in the remdesivir arm., Anti-TBE (IgG, IgM, and/or IgA) and neutralizing antibody concentrations in CSF, blood and/or saliva (before and/or after treatment initiation) in relation to NfL/GFAP and/or the composite cognitive score at Week 4, analyzed comparatively between treatment arms, Concentrations of anti–type I interferon autoantibodies in CSF and/or blood in relation to NfL/GFAP and/or the composite cognitive score at Week 4, analyzed comparatively between treatment arms., Detection and/or quantification of TBEV RNA in CSF, blood, and saliva (before and/or after treatment initiation) in relation to NfL/GFAP and/or the composite cognitive score at Week 4, analyzed comparatively between treatment arms., Host genomic variants in relation to NfL/GFAP and/or the composite cognitive score at Week 4, analyzed comparatively between treatment arms., Host proteomic signatures in relation to NfL/GFAP and/or the composite cognitive score at Week 4, analyzed comparatively between treatment arms.

Source: https://euclinicaltrials.eu/ctis-public/view/2025-523476-23-00